EU clinical trial 2024-515118-42-00: FLUOCOL-1 : Intraoperative Indocyanine Green Fluorescence Angiography in Colorectal Surgery to Prevent Anastomotic Leakage
Sponsor: Centre Hospitalier Regional Universitaire (Hospital/Clinic/Other health care facility). Phase: Phase III and phase IV (Integrated). Countries: France (ongoing, recruiting).
Therapeutic area(s): Diseases [C] - Digestive System Diseases [C06]; Diseases [C] - Neoplasms [C04]
Gender: Female, Male. Age: 18-64 years, 65+ years. Enrolment: 1010.
Status: Ongoing, recruiting. Start date (EU): 2024-09-10. Decision date: 2024-09-10. Results received: No. Last updated: 2026-01-15.

Condition(s): Colorectal cancer
Product: INFRACYANINE 25 mg/10 mL, poudre et solvant pour solution injectable

Primary endpoint: The primary endpoint is the occurrence of an anastomotic leakage 90-days post-operation. Anastomotic leakage is defined as any anastomotic dehiscence with leakage into the pelvic cavity diagnosed upon imaging or at surgical exploration or any isolated pelvic organ-space infection with no evidence of fistula as defined by the International Study Group of Rectal Cancer
Endpoint(s): Change in planned anastomosis during surgery defined as any decision change upon perfusion assessment such as modifying the initially planned transection level of the descending colon or refashioning anastomosis including the decision to undertake a permanent stoma rather than an anastomosis, Rate of defunctioning stoma, Overall 90-day postoperative morbidity, including all complications according to the Clavien-Dindo classification, and occurring within 90 days after surgery, Postoperative mortality, including all deaths occurring within 90 days after surgery, Duration of hospital stay, calculated from the day of surgery to the day of hospital discharge, Postoperative reintervention within 90 days, HRQoL using the QLQ-C30 and QLQ-CR29 at baseline and 90 days post-operation, Medico-economic interest of IOFA with ICG use

Source: https://euclinicaltrials.eu/ctis-public/view/2024-515118-42-00